EU clinical trial 2024-520348-40-00: A Comparative Trial on Scabies Treatments: Topical Permethrin, Oral Ivermectin and Combination of Topical Permethrin and Oral Ivermectin
Protocol code: GIU_PER_IV_0024
Sponsor: Giuliani S.p.A. (Pharmaceutical company). Phase: Therapeutic use (Phase IV). Countries: Italy (ongoing, recruiting).
Therapeutic area(s): Diseases [C] - Skin and Connective Tissue Diseases [C17]
Gender: Female, Male. Age: 18-64 years, 65+ years. Enrolment: 156.
Status: Ongoing, recruiting. Start date (EU): 2025-10-02. Decision date: 2025-07-08. Results received: No. Last updated: 2025-07-08.

Condition(s): Clinical and light microscopy confirmed scabies
Product: SCABIACID 5% crema, IVERMECTINA GIULIANI 3 mg compresse

Primary endpoint: Percentage of subjects (Score 0; see below) with Complete cure rate (CCR) at Visit 1 (week 1)
Endpoint(s): Percentage of subjects (Score 0; see below) with Complete cure rate (CCR) at Visit 2 (week 2), Percentage of Subjects with score 0 or 1 at week 1, Percentage of subjects with CCR at week 2, Percentage of subjects with score 0 or 1 at week 2, Subjective evaluation of itching at week 1 and 2, Percentage of treatment failure at week 1 and week 2 (treatment failure is defined as: no improvement at all of itching intensity and skin lesions count and/or appearance of new lesions), Safety and Tolerability endpoints: (at week 1, week 2) - Evaluation and recording of spontaneous reported adverse events - Blood pressure monitoring - Heart rate

Source: https://euclinicaltrials.eu/ctis-public/view/2024-520348-40-00